EU clinical trial 2024-519726-20-00: Pre- vs. postoperative thromboprophylaxis for liver resection – a prospective, multicentre, randomized controlled trial (PREPOSTEROUS trial)
Protocol code: PREPOSTEROUS
Sponsor: Oslo University Hospital HF (Hospital/Clinic/Other health care facility). Phase: Therapeutic use (Phase IV). Countries: Norway (ongoing, recruiting).
Therapeutic area(s): Diseases [C] - Hemic and Lymphatic Diseases [C15]
Gender: Female, Male. Age: 18-64 years, 65+ years. Enrolment: 500.
Status: Ongoing, recruiting. Start date (EU): 2022-03-17. Decision date: 2024-12-19. Results received: No. Last updated: 2024-12-19.

Condition(s): Liver surgery
Product: DALTEPARIN, ENOXAPARIN

Primary endpoint: Venous thromboembolisms, number of patients, within 30 days from liver resection.
Endpoint(s): 1) Posthepatectomy haemorrhage, any grade in ISGLS classification, number of patients, within 30 days from liver resection 2) Comprehensive Complication Index – score, within 30 days from liver resection 3) Length of postoperative hospital stay, days 4) Total amount of transfused red blood cells, units, during and within 30 days from liver resection

Source: https://euclinicaltrials.eu/ctis-public/view/2024-519726-20-00